EU clinical trial 2023-505112-38-00: Randomized controlled multicenter study comparing efficacy and safety of adalimumab to that of mycophenolate mofetil in steroid dependent non-infectious uveitis. FOCUS: treatment FOr Corticosteroid dependent UveitiS
Protocol code: APHP211032
Sponsor: Assistance Publique Hopitaux De Paris (Hospital/Clinic/Other health care facility). Phase: Phase III and phase IV (Integrated). Countries: France (ongoing, recruiting).
Therapeutic area(s): Diseases [C] - Immune System Diseases [C20]; Diseases [C] - Eye Diseases [C11]
Gender: Female, Male. Age: 18-64 years, 65+ years. Enrolment: 120.
Status: Ongoing, recruiting. Start date (EU): 2024-07-01. Decision date: 2023-10-26. Results received: No. Last updated: 2025-04-22.

Condition(s): recently active non-infectious intermediate, posterior, and pan-uveitis
Product: MYCOPHENOLATE MOFETIL, RIFINAH 300 mg/150 mg, comprimé enrobé, Humira 40 mg solution for injection in pre-filled pen, FLUORESCEIN SODIUM, INDOCYANINE GREEN, PREDNISONE

Primary endpoint: The primary efficacy endpoint is the treatment failure rate at 36 weeks. Treatment failure is defined by any of the following in at least one eye: new active, inflammatory chorioretinal or retinal vascular lesions; worsening of best corrected visual acuity (BCVA) by>3 lines; 2-step increase in anterior chamber cell grade and/or in vitreous haze relative to baseline ; absence of steroid discontinuation between week 13 and week 19 or any additional immunosuppressive drug or injectable steroids
Endpoint(s): Time to treatment failure up to W55, Snellen BCVA in each eye, at W4, W8, W12, W16, W20, W24, W30, W36 and W55, Anterior chamber cell grade in each at W4, W8, W12, W16, W20, W24, W30, W36 and W55, Vitreous haze grade (SUN criteria) in each eye at W4, W8, W12, W16, W20, W24, W30, W36 and W55, Central retinal thickness in each eye from baseline at W4, W8, W12, W16, W20, W24, W30, W36 and W55, Proportion of patients with central macular thickness< 300 microns at W4, W8, W12, W16, W20, W24, W30, W36 and W55, Time to optical coherence tomographic (OCT) evidence of macular edema in at least one eye, up to W55, NEI Visual Functioning Questionaire-25 (VFQ-25) composite score, at W12, W24, and W36, Measures of corticosteroid sparing (e.g., percent meeting targets [<0.1 mg/kg/day prednisone], mean change, mean dose at week 55, and cumulative dose), Cumulative incidence of relapse and number of relapses up to W55, Safety and tolerability of treatments as assessed by the frequency and severity of adverse events and treatment discontinuation from baseline to Week 55, - Percentage of patients without chorioretinal or vascular lesions on retinal angiography, up to w36

Source: https://euclinicaltrials.eu/ctis-public/view/2023-505112-38-00